EU clinical trial 2024-517745-14-00: A Phase 2, Randomized, Double-Blind, Four-Arm, Placebo-Controlled, Multicenter Study Assessing the Efficacy, Safety and Tolerability of three doses of orally administered BMS-986368, a FAAH/MAGL Inhibitor, for the treatment of Spasticity in Participants with Multiple Sclerosis (BALANCE-MSS-1)
Protocol code: IM045-1018
Sponsor: Celgene Corp. (Pharmaceutical company). Phase: Therapeutic exploratory (Phase II). Countries: Germany (ongoing, recruiting), Czechia (ongoing, recruiting), Poland (ongoing, recruiting).
Therapeutic area(s): Diseases [C] - Immune System Diseases [C20]; Diseases [C] - Nervous System Diseases [C10]
Gender: Female, Male. Age: 18-64 years, 65+ years. Enrolment: 100.
Status: Ongoing, recruiting. Start date (EU): 2025-09-24. Decision date: 2025-09-08. Results received: No. Last updated: 2026-08-04.
Decision dates by country: PL: 2025-09-12, DE: 2025-09-12, CZ: 2025-09-08

Condition(s): Multiple Sclerosis Spasticity
Product: CC-97489 1mg , CC-97489 3mg, CC-97489, CC-97489

Primary endpoint: The way we are measuring the main study goals (the main trial endpoint) is by looking at how much the stiffness in the person's most affected leg changes from the start of the study to the end of Week 6. We will use a tool called the Total Numeric-transformed Modified Ashworth Scale-Most Affected Lower Limb (TNmAS-MALL) to measure this
Endpoint(s): The secondary trial endpoints include the Numeric Rating Scale-Spasticity (NRS-S), which is a question answered every day using an eDiary provided to the participant., Other secondary endpoints include the MS Spasticity Scale (MSSS-88), a set of questions asking about spasticity in the participant’s daily life, the Timed 25-Foot Walk (T25FW) test, a test to see how long it takes the participant to walk 25 feet, and the Clinical Global Impression of Severity, a question for the investigator to determine how severe the participant’s condition is.

Source: https://euclinicaltrials.eu/ctis-public/view/2024-517745-14-00